EU clinical trial 2023-503423-25-00: HOVON 127 BL / SAKK 37/16: Phase III study comparing R-CODOX-M/R-IVAC versus dose-adjusted EPOCH-R (DA-EPOCH-R) for patients with newly diagnosed high risk Burkitt lymphoma
Protocol code: HOVON 127 BL
Sponsor: Haemato Oncology Foundation For Adults Netherlands (Hospital/Clinic/Other health care facility). Phase: Therapeutic confirmatory (Phase III). Countries: Belgium (ongoing, recruitment ended), Netherlands (ongoing, recruitment ended).
Therapeutic area(s): Diseases [C] - Hemic and Lymphatic Diseases [C15]
Gender: Female, Male. Age: 18-64 years, 65+ years. Enrolment: 69.
Status: Ongoing, recruitment ended. Start date (EU): 2014-06-19. Decision date: 2024-09-11. Results received: No. Last updated: 2024-09-16.
Decision dates by country: BE: 2024-09-16, NL: 2024-09-11

Condition(s): Burkitt lymphoma
Product: METHOTREXATE, IFOSFAMIDE, VINCRISTINE, CYCLOPHOSPHAMIDE, RITUXIMAB, ETOPOSIDE, CYTARABINE, PREDNISOLONE, DOXORUBICIN

Primary endpoint: 2-year PFS; defined as time from randomisation to disease progression, relapse or death, whichever comes first. Patients still alive or lost to follow up are censored at the date they were last known to be alive
Endpoint(s): ORR end-of-treatment, EFS at 2 years; defined as time from randomisation to first event (death from any cause, no CR, relapse, whichever comes first)., OS at 2 years; defined as time from randomisation until death from any cause; patients still alive or lost to follow up are censored at the date they were last known to be alive, Rate of CTCAE grade ≥3 toxicities, Number of hospitalization days

Source: https://euclinicaltrials.eu/ctis-public/view/2023-503423-25-00